EU clinical trial 2023-507293-40-00: B7471015 - A PHASE 4 STUDY USING A TEST-NEGATIVE DESIGN TO EVALUATE THE EFFECTIVENESS OF A 20-VALENT PNEUMOCOCCAL CONJUGATE VACCINE AGAINST VACCINE-TYPE RADIOLOGICALLY-CONFIRMED COMMUNITY-ACQUIRED PNEUMONIA IN ADULTS ≥65 YEARS OF AGE
Protocol code: B7471015
Sponsor: Pfizer Inc. (Pharmaceutical company). Phase: Therapeutic use (Phase IV). Countries: Spain (ongoing, recruiting).
Therapeutic area(s): Diseases [C] - Bacterial Infections and Mycoses [C01]
Gender: Female, Male. Age: 65+ years. Enrolment: 4600.
Status: Ongoing, recruiting. Start date (EU): 2024-04-11. Decision date: 2024-03-04. Results received: No. Last updated: 2026-05-08.

Condition(s): VACCINE-TYPE RADIOLOGICALLY-CONFIRMED COMMUNITY-ACQUIRED PNEUMONIA
Product: Apexxnar suspension for injection in pre-filled syringe Pneumococcal polysaccharide conjugate vaccine (20-valent, adsorbed), Apexxnar suspension for injection in pre-filled syringe Pneumococcal polysaccharide conjugate vaccine (20-valent, adsorbed), Apexxnar suspension for injection in pre-filled syringe Pneumococcal polysaccharide conjugate vaccine (20-valent, adsorbed), Apexxnar suspension for injection in pre-filled syringe Pneumococcal polysaccharide conjugate vaccine (20-valent, adsorbed), Apexxnar suspension for injection in pre-filled syringe Pneumococcal polysaccharide conjugate vaccine (20-valent, adsorbed), Apexxnar suspension for injection in pre-filled syringe Pneumococcal polysaccharide conjugate vaccine (20-valent, adsorbed)

Primary endpoint: VE calculated as 1 minus the OR for 20vPnC vaccination among cases and controls multiplied by 100 adjusted for potentially confounding variables.
Endpoint(s): VE calculated as 1 minus the OR for 20vPnC vaccination among cases versus controls* multiplied by 100 adjusted for potentially confounding variables., VE calculated as 1 minus the OR of 20vPnC vaccination among cases and controls multiplied by 100 adjusted for potentially confounding variables, using data from European/Israeli participants, Among participants with RAD+CAP: • VE by age group (i.e., 65–74 years, 75–84 years, and ≥85 years) • VE by sex (i.e., male vs female) • VE by ACIP-defined risk group and by age group, VE by prior influenza vaccination in past 12 months (ie, vaccinated vs. non-vaccinated); VE by co-administration of influenza vaccination, VE against 13vPnC serotypes, the 7 additional serotypes in 20vPnC beyond 13vPnC plus 15C and 20vPnC serotypes by previous vaccination with 13vPnC, VE against individual serotypes, VE against the 13 shared serotypes contained in 20vPnC and 13vPnC

Source: https://euclinicaltrials.eu/ctis-public/view/2023-507293-40-00